EU clinical trial 2024-520386-31-00: A Phase 3 (Pivotal Stage) Study of NBTXR3 Activated by Investigator’s Choice of Radiotherapy Alone or Radiotherapy in Combination with Cetuximab for Platinum-based Chemotherapy-Ineligible Elderly Patients with Locally Advanced Head & Neck Squamous Cell Carcinoma
Protocol code: NANORAY-312
Sponsor: Johnson & Johnson Enterprise Innovation Inc. (Pharmaceutical company). Phase: Therapeutic confirmatory (Phase III). Countries: Greece (ongoing, recruiting), Portugal (ongoing, recruiting), Belgium (ongoing, recruiting), France (ongoing, recruiting), Spain (ongoing, recruiting), Germany (ongoing, recruiting), Hungary (ongoing, recruiting), Romania (ongoing, recruiting), Austria (ongoing, recruiting), Czechia (ongoing, recruitment ended).
Therapeutic area(s): Diseases [C] - Neoplasms [C04]
Gender: Female, Male. Age: 18-64 years, 65+ years. Enrolment: 194.
Start date (EU): 2025-09-22. Decision date: 2025-06-25. Results received: No. Last updated: 2026-03-13.
Decision dates by country: BE: 2025-06-25, DE: 2025-08-07, HU: 2025-06-27, RO: 2025-06-30, CZ: 2025-12-22, ES: 2025-06-27, AT: 2025-06-29, FR: 2025-06-25, PT: 2025-06-25, GR: 2025-06-25

Condition(s): Locally Advanced Head & Neck Squamous Cell Carcinoma
Product: Erbitux 5 mg/mL solution for infusion, JNJ-90301900

Primary endpoint: Progression-free survival (PFS): time from randomization to loco-regional recurrence, loco-regional progression, distant progression, or death from any cause, whichever occurs first

Source: https://euclinicaltrials.eu/ctis-public/view/2024-520386-31-00